EU clinical trial 2024-513352-15-00: Norfloxacin for amelioration of portal hypertension in decompensated cirrhosis - a randomized, placebo-controlled, double-blinded clinical trial
Protocol code: NOPE
Sponsor: Medical University Of Vienna (Educational Institution). Phase: Therapeutic exploratory (Phase II). Countries: Austria (ongoing, recruiting).
Therapeutic area(s): Diseases [C] - Digestive System Diseases [C06]
Gender: Female, Male. Age: 18-64 years, 65+ years. Enrolment: 150.
Status: Ongoing, recruiting. Start date (EU): 2025-02-04. Decision date: 2024-12-09. Results received: No. Last updated: 2025-08-11.

Condition(s): Portal hypertension, Decompensated cirrhosis
Product: Floxacin 400 mg Filmtabletten, Placebo consists of gelatine capsules filled with maltodextrin

Primary endpoint: Change in HVPG at 12 weeks compared to baseline in the treatment group as compared to placebo
Endpoint(s): Incidence of liver-related complications at 12 weeks and at 24 weeks (Spontaneous bacterial peritonitis, Hepatorenal syndrome, Variceal bleeding, Jaundice, Large-volume ascites, Overt hepatic encephalopathy, Any other major infection (pneumonia, sepsis…), Acute-on-chronic liver failure (ACLF), Liver-related death), Liver-related mortality, Biomarkers of bacterial translocation and systemic inflammation at 12 weeks (on-drug) and at 24 weeks (off-drug), Patient-reported outcomes/HRQoL (using validated questionnaires: SF-36 v2.0, CLDQ, FSS) at 12 weeks (on-drug) and at 24 weeks (off-drug), Stool microbiome composition at baseline vs. week 12, Blood metabolomic signatures at baseline vs. week 12

Source: https://euclinicaltrials.eu/ctis-public/view/2024-513352-15-00